EU clinical trial 2024-513729-22-01: Phase I study of 225Ac-PSMA I&T in prostate cancer
Sponsor: Erasmus Universitair Medisch Centrum Rotterdam (Erasmus MC) (Hospital/Clinic/Other health care facility). Phase: Human Pharmacology (Phase I)- Bioequivalence Study. Countries: Netherlands (ongoing, recruiting).
Therapeutic area(s): Analytical, Diagnostic and Therapeutic Techniques and Equipment [E] - Therapeutics [E02]
Gender: Male. Age: 18-64 years, 65+ years. Enrolment: 30.
Status: Ongoing, recruiting. Start date (EU): 2022-02-01. Decision date: 2024-09-24. Results received: No. Last updated: 2025-06-30.

Condition(s): metastatic prostate cancer

Source: https://euclinicaltrials.eu/ctis-public/view/2024-513729-22-01